EU clinical trial 2022-500094-14-00: A Phase 1 Study of SGN-ALPV in Advanced Solid Tumors
Protocol code: SGNALPV-001
Sponsor: Seagen Inc. (Pharmaceutical company). Phase: Human Pharmacology (Phase I)- First administration to humans. Countries: Spain (ended), Sweden (ended), Netherlands (ended), Denmark (not authorised).
Therapeutic area(s): Diseases [C] - Neoplasms [C04]
Gender: Female, Male. Age: 18-64 years, 65+ years. Enrolment: 82.
Status: Ended. Start date (EU): 2022-11-08. End date (EU): 2023-10-09. End date: 2023-12-13. Decision date: 2022-07-26. Results received: Yes. Last updated: 2023-09-25.
Decision dates by country: ES: 2022-07-26, NL: 2023-01-23, SE: 2022-12-20

Condition(s): gastroesophageal junction [GEJ] carcinoma, Non-small cell lung cancer (NSCLC), Gastric cancer, Cervical cancer, Ovarian cancer, Endometrial cancer, Malignant ovarian GCT with the exception of pure teratomas, Malignant testicular germ cell tumor (GCT) with the exception of pure teratomas, Gastroesophageal junction carcinoma, Malignant extragonadal GCT with the exception of pure teratomas or tumors with primaries arising from the central nervous system (CNS)
Product: SGN-ALPV

Primary endpoint: Type, incidence, severity, seriousness, and relatedness of adverse events (AEs) and type, incidence, and severity of laboratory abnormalities, Incidence of dose-limiting toxicities (DLTs), Incidence of DLTs and cumulative safety by dose level
Endpoint(s): Incidence of antidrug antibodies (ADAs), Estimates of PK parameters including area under the concentration-time curve (AUC), maximum concentration (Cmax), time to Cmax (Tmax), apparent terminal half-life (t½), and trough concentration (Ctrough). Additional parameters may be evaluated as necessary, Objective response rate (ORR) per Response Evaluation Criteria in Solid Tumors Version 1.1 (RECIST v1.1), Duration of objective response (DOR), Progression-free survival (PFS), Overall survival (OS), CA-125 response rate according to Gynecological Cancer Intergroup (GCIG) criteria (subjects with ovarian cancer only), Combined RECIST/CA-125 overall response rate according to GCIG (subjects with ovarian cancer only)

Source: https://euclinicaltrials.eu/ctis-public/view/2022-500094-14-00